EU clinical trial 2024-516619-26-00: A clinical study of MK-3508 in healthy people (MK-3508-006)
Protocol code: MK-3508-006
Sponsor: Merck Sharp & Dohme LLC (Pharmaceutical company). Phase: Human Pharmacology (Phase I)- Other. Countries: Belgium (ended).
Therapeutic area(s): Diseases [C] - Virus Diseases [C02]
Gender: Female, Male. Age: 18-64 years. Enrolment: 12.
Status: Ended. Start date (EU): 2024-11-04. End date (EU): 2025-01-06. End date: 2025-01-07. Decision date: 2024-10-23. Results received: No. Last updated: 2024-10-23.

Condition(s): Respiratory syncytial virus infection

Source: https://euclinicaltrials.eu/ctis-public/view/2024-516619-26-00